EU clinical trial 2024-518786-10-01: A Randomized, Double-Blind, Placebo Controlled, Dose-Ranging Study Evaluating the Efficacy and Safety of EVO756 in Adults with Moderate to Severe Chronic Spontaneous Urticaria.
Protocol code: EVO756-CSU001
Sponsor: Evommune Inc. (Pharmaceutical company). Phase: Therapeutic exploratory (Phase II). Countries: Poland (ended), Germany (ended), Italy (ended), Hungary (ended), Bulgaria (ended), Spain (ended).
Therapeutic area(s): Diseases [C] - Skin and Connective Tissue Diseases [C17]
Gender: Female, Male. Age: 18-64 years, 65+ years. Enrolment: 63.
Status: Ended. End date (EU): 2026-06-05. End date: 2026-06-06. Decision date: 2025-06-19. Results received: No. Last updated: 2026-06-04.
Decision dates by country: ES: 2025-06-19, HU: 2025-06-20, PL: 2025-06-24, DE: 2025-06-23, BG: 2025-06-20, IT: 2025-07-02

Condition(s): Moderate to Severe Chronic Spontaneous Urticaria
Product: PLACEBO, EVO756 Potassium, EVO756 Potassium, EVO756 Potassium

Primary endpoint: Mean change from baseline in UAS7 at Week 12
Endpoint(s): Percent change from baseline in UAS7 at Week 12, Mean and percent change from baseline in UAS7 at Weeks 1, 2, 4, 8, Mean and percent change from baseline in ISS7 at Weeks 1, 2, 4, 8, 12, Mean and percent change from baseline in HSS7 at Weeks 1, 2, 4, 8, 12, Mean and percent change from baseline in AAS7 at Weeks 1, 2, 4, 8, 12, Proportion of subjects achieving UAS7 ≤ 6 and UAS7 = 0

Source: https://euclinicaltrials.eu/ctis-public/view/2024-518786-10-01